EU clinical trial 2024-511972-33-00: A Phase 3, multicenter, open-label, randomized study to evaluate the efficacy and safety of fedratinib compared to best available therapy in subjects with DIPSS - intermediate or high-risk primary myelofibrosis, post-polycythemia vera myelofibrosis, or post-essential thrombocythemia myelofibrosis and previously treated with ruxolitinib
Protocol code: FEDR-MF-002
Sponsor: Celgene Corp. (Pharmaceutical company). Phase: Therapeutic confirmatory (Phase III). Countries: Belgium (ended), Italy (ended), Hungary (ended), France (ended), Czechia (ended), Germany (ended), Poland (ended), Ireland (ended), Austria (ended), Spain (ended).
Therapeutic area(s): Diseases [C] - Hemic and Lymphatic Diseases [C15]
Gender: Female, Male. Age: 18-64 years, 65+ years. Enrolment: 144.
Status: Ended. Start date (EU): 2019-08-05. End date (EU): 2025-07-23. End date: 2025-07-28. Decision date: 2024-05-07. Results received: Yes. Last updated: 2025-03-26.
Decision dates by country: BE: 2024-05-08, FR: 2024-05-14, PL: 2024-05-31, HU: 2024-05-08, CZ: 2024-05-13, IE: 2024-05-07, ES: 2024-05-13, AT: 2024-05-21, DE: 2024-05-08, IT: 2024-05-08

Condition(s): Primary myelofibrosis, post-polycythemia vera myelofibrosis , or post-essential thrombocythemia myelofibrosis
Product: DANAZOL, BUSULFAN, POMALIDOMIDE, FEDRATINIB, RUXOLITINIB, PEGFILGRASTIM, HYDROXYCARBAMIDE, PEGINTERFERON ALFA-2A

Primary endpoint: Spleen volume response rate (RR)
Endpoint(s): Symptom response rate (SRR), Spleen volume response rate (RR25)

Source: https://euclinicaltrials.eu/ctis-public/view/2024-511972-33-00